EU clinical trial 2023-503408-10-00: AML-NET : Acute Myeloid Leukemia treated with with NETrin Abs in combination with [AZACITIDINE + VENETOCLAX]
Protocol code: ET23-026
Sponsor: Centre Leon Berard (Hospital/Clinic/Other health care facility). Phase: Phase I and Phase II (Integrated)- Other. Countries: France (ended).
Therapeutic area(s): Diseases [C] - Neoplasms [C04]
Gender: Female, Male. Age: 65+ years. Enrolment: 35.
Status: Ended. Start date (EU): 2024-09-08. End date (EU): 2025-07-04. Decision date: 2023-08-25. Results received: No. Last updated: 2025-07-04.

Condition(s): Refractory Acute Myeloïd Leukemia

Source: https://euclinicaltrials.eu/ctis-public/view/2023-503408-10-00